EU clinical trial 2023-507886-25-00: MALIBU trial - Phase II study of combination ibrutinib and rituximab in untreated marginal zone lymphomas
Protocol code: IELSG47
Sponsor: Association International Extranodal Lymphoma Study Group (IELSG) (Laboratory/Research/Testing facility). Phase: Therapeutic exploratory (Phase II). Countries: France (ongoing, recruitment ended), Belgium (ongoing, recruitment ended), Italy (ongoing, recruitment ended), Portugal (ongoing, recruitment ended).
Therapeutic area(s): Diseases [C] - Neoplasms [C04]
Gender: Female, Male. Age: 18-64 years, 65+ years. Enrolment: 178.
Status: Ongoing, recruitment ended. Start date (EU): 2019-09-27. Decision date: 2024-06-03. Results received: No. Last updated: 2026-03-13.
Decision dates by country: BE: 2024-06-10, PT: 2024-06-03, IT: 2024-06-10, FR: 2024-06-05

Condition(s): Previously untreated and symptomatic patients with histologically proven CD20-positive marginal zone B-cell lymphoma (MZL) in need of systemic treatment
Product: MabThera 500 mg concentrate for solution for infusion, MabThera 1400 mg solution for subcutaneous injection, IMBRUVICA 140 mg hard capsules

Primary endpoint: a) Complete Response (CR) rate at 12 months b) PFS at 5 years assessed by the investigators, according to revised response criteria for malignant lymphomas, from study entry to death from any cause or PD
Endpoint(s): Acute and long-term safety evaluated by assessment of laboratory parameters and adverse events coded with NCI Common Toxicity Criteria, version 4.0, Complete Response rate at 24 months, Overal Response Rate (ORR) at 12 and 24 months, Overall Survival

Source: https://euclinicaltrials.eu/ctis-public/view/2023-507886-25-00